EU clinical trial 2024-511793-71-00: A Phase 1/2 Study of the Highly Selective ROS1 Inhibitor NVL-520 in Patients with Advanced NSCLC and Other Solid Tumors (ARROS-1)
Protocol code: NVL-520-01
Sponsor: Nuvalent Inc. (Pharmaceutical company). Phase: Phase I and Phase II (Integrated)- First administration to humans. Countries: Netherlands (ongoing, recruiting), Italy (ongoing, recruiting), France (ongoing, recruiting), Belgium (ongoing, recruiting), Germany (ongoing, recruiting), Spain (ongoing, recruiting).
Therapeutic area(s): Diseases [C] - Neoplasms [C04]
Gender: Female, Male. Age: 0-17 years, 18-64 years, 65+ years. Enrolment: 283.
Status: Ongoing, recruiting. Start date (EU): 2022-02-28. Decision date: 2024-04-23. Results received: No. Last updated: 2026-07-30.
Decision dates by country: BE: 2024-04-23, NL: 2024-04-24, DE: 2024-04-25, FR: 2024-04-29, ES: 2024-04-24, IT: 2024-04-26

Condition(s): Advanced ROS1-positive NSCLC and other advanced ROS1-positive solid tumors
Product: NVL-520, NVL-520

Primary endpoint: Phase 1 • RP2D and, if applicable, the MTD as determined by incidence of DLTs during Cycle 1, overall safety profile, PK, PD, and preliminary efficacy Phase 2 • ORR per RECIST 1.1.
Endpoint(s): • Incidence and severity of treatment-emergent adverse events (TEAEs) and changes in clinically relevant laboratory parameters • Pharmacokinetic parameters of NVL-520 − Maximum plasma concentration (Cmax); Cmax – dose normalized, plasma concentration at the end of the dosing interval (Ctau); average plasma concentration (Cavg); time of maximum concentration (Tmax); Please refer to protocol for further end points due to word limitation.

Source: https://euclinicaltrials.eu/ctis-public/view/2024-511793-71-00